EU clinical trial 2023-503772-24-00: A Phase 2b/3, Multi-part, Randomized, Double-Blinded, Placebo-Controlled Study to Evaluate the Efficacy and Safety of Atacicept in Subjects with IgA Nephropathy (IgAN)
Protocol code: VT-001-0050
Sponsor: Vera Therapeutics Inc. (Pharmaceutical company). Phase: Phase II and Phase III (Integrated). Countries: Germany (ongoing, recruitment ended), Czechia (ongoing, recruitment ended), Belgium (ongoing, recruitment ended), Greece (ongoing, recruitment ended), Poland (ongoing, recruitment ended), Denmark (ongoing, recruitment ended), Portugal (ongoing, recruitment ended), Ireland (ongoing, recruitment ended), Spain (ongoing, recruitment ended), Croatia (ongoing, recruitment ended), Estonia (ongoing, recruitment ended), France (ongoing, recruitment ended), Italy (ongoing, recruitment ended).
Therapeutic area(s): Diseases [C] - Pathological Conditions, Signs and Symptoms [C23]
Gender: Female, Male. Age: 18-64 years, 65+ years. Enrolment: 216.
Status: Ongoing, recruitment ended. Start date (EU): 2021-09-15. Decision date: 2023-04-28. Results received: No. Last updated: 2026-04-07.
Decision dates by country: HR: 2024-09-22, EE: 2024-08-19, DE: 2023-04-28, GR: 2023-05-29, PL: 2023-06-05, CZ: 2023-05-02, DK: 2024-09-06, FR: 2024-09-05, PT: 2024-09-12, ES: 2024-08-30, IE: 2024-09-20, IT: 2024-09-23, BE: 2023-05-31

Condition(s): IgA Nephropathy
Product: Atacicept, Atacicept, Placebo of Atacicept, Atacicept, LOSARTAN, ENALAPRIL

Primary endpoint: Phase 2b_01. Urine protein to creatinine ratio (UPCR) week 24. Phase 3_01. Urine protein to creatinine ratio (UPCR) week 36, Phase 3_01. Urine protein to creatinine ratio (UPCR) week 36
Endpoint(s): Phase 2b_01. Urine protein to creatinine ratio (UPCR) week 36. Phase 3_01. Annualized Rate of change in eGFR (ie., annualized eGFR total slope) week 104, Phase 3_01. Annualized Rate of change in eGFR (ie., annualized eGFR total slope) week 104

Source: https://euclinicaltrials.eu/ctis-public/view/2023-503772-24-00